EU clinical trial 2023-507537-16-00: A phase I/II, single arm, open label study of dasatinib as toxicity prophylaxis in the context of therapy with idecabtagene vicleucel in relapsed/refractory multiple myeloma
Protocol code: CARiDA
Sponsor: Universitaetsklinikum Wuerzburg AöR (Hospital/Clinic/Other health care facility). Phase: Phase I and Phase II (Integrated)- Other. Countries: Germany (authorised, recruitment pending).
Therapeutic area(s): Diseases [C] - Hemic and Lymphatic Diseases [C15]; Diseases [C] - Immune System Diseases [C20]
Gender: Female, Male. Age: 18-64 years, 65+ years. Enrolment: 55.
Status: Authorised, recruitment pending. Decision date: 2024-02-15. Results received: No. Last updated: 2025-12-17.

Condition(s): Chimeric antigen receptor T cell therapy-associated cytokine release syndrome
Product: Abecma 260 - 500 x 10^6 cells dispersion for infusion, SPRYCEL 140 mg film-coated tablets

Primary endpoint: Number of TEAEs (phase I and II) and DLT rate (phase I):Type, frequency, and severity of TEAEs, will be assessed and graded according to the Common Terminology Criteria for Adverse Events (CTCAE) version 5.0; Time frame: day -2 to day 30, Frequency and severity of any grade CRS. CRS is assessed using American Society for Blood and Marrow Transplantation (ASBMT) CRS Consensus Grading; Time frame: day 0 to day 30
Endpoint(s): CRS frequency and severity of Grade 2-5 CRS is assessed using the American Society for Blood and Marrow Transplantation (ASBMT) CRS Consensus Grading; Time frame: day 0 to day 30, Time to onset of any grade CRS; Time frame: day 0 to day 30, Time between CRS (any grade) onset to CRS resolution. Assessed using ASBMT CRS Consensus Grading. Time frame: day 0 to day 30, Frequency and severity of any grade ICANS. ICANS are assessed using the ASBMT ICANS Consensus Grading. Time frame: day 0 to day 30, Time to onset of any grade ICANS, assessed using the AS-BMT ICANS Consensus Grading. Time frame: day 0 to day 30, Time between onset of any grade ICANS until ICANS resolution, assessed using the ASBMT ICANS Consensus Grading. Time frame: day 0 to day 30, Occurrence and duration of prolonged (present at day 30 or later) and/or severe (CTCAE version 5.0 grade 3 or higher) cytopenia. Time frame: day -2 to day 360, Occurrence and duration of severe (CTCAE version 5.0 grade 3 or higher) infections. Time frame: day -2 to day 360, Overall response rate, complete response rate and duration of response and progression free survival according to IMWG criteria Time frame: day 0 to day 360, Progression free survival and overall survival with the Kaplan-Meier method. Time frame: day 0 to day 360, Number of hospital admissions post treatment with ide-cel for subjects with CRS and/or ICANS and duration of hospital stays, time of first discharge. Time frame: day 0 to day 360, Number of ICU admissions due to CRS and/or ICANS and duration of stays. Time frame: day 0 to day 360, Changes in Health-related Quality of Life (HRQoL) assessed by European Organisation for Research and Treatment of Cancer (EORTC QLQ-C30/-MY20). Time frame: day 0 to day 360

Source: https://euclinicaltrials.eu/ctis-public/view/2023-507537-16-00